EU clinical trial 2022-500862-93-00: ERASE PH-COPD
Protocol code: APHP211052
Sponsor: Assistance Publique Hopitaux De Paris (Hospital/Clinic/Other health care facility). Phase: Therapeutic confirmatory (Phase III). Countries: France (ongoing, recruiting).
Therapeutic area(s): Diseases [C] - Respiratory Tract Diseases [C08]
Gender: Female, Male. Age: 18-64 years, 65+ years. Enrolment: 200.
Status: Ongoing, recruiting. Start date (EU): 2024-02-01. Decision date: 2023-04-20. Results received: No. Last updated: 2026-07-07.

Condition(s): Pulmonary Hypertension

Source: https://euclinicaltrials.eu/ctis-public/view/2022-500862-93-00